EU clinical trial 2024-512898-27-00: An open-label phase 1/2 study to evaluate the safety, biological response and efficacy of a single dose of Temferon (autologous CD34+-enriched hematopoietic stem and progenitors cells genetically modified with human Interferon-α2) in patients with metastatic renal cell carcinoma
Protocol code: TEM-GU
Sponsor: Genenta Science S.p.A. (Pharmaceutical company). Phase: Phase I and Phase II (Integrated)- Other. Countries: Italy (ended).
Therapeutic area(s): Diseases [C] - Neoplasms [C04]
Gender: Female, Male. Age: 18-64 years, 65+ years. Enrolment: 12.
Status: Ended. Start date (EU): 2024-10-22. End date (EU): 2026-01-23. Decision date: 2024-09-30. Results received: Yes. Last updated: 2025-09-17.

Condition(s): Patients with locally advanced/metastatic renal cell carcinoma with evidence of disease progression following standard of care treatment
Product: CABOZANTINIB, LENOGRASTIM, PLERIXAFOR, BUSULFAN, CABOZANTINIB, TEMFERON, PEMBROLIZUMAB, FILGRASTIM

Primary endpoint: To assess tolerability and safety of conditioning and Temferon over a defined period of time following Temferon administration, as evaluated by: - routine clinical and laboratory surveillance; - assessment of autoimmune manifestations; - incidence of adverse events, To assess the biological activity of Temferon in the tumor of patients with metastatic RCC at a defined period of time following Temferon administration.
Endpoint(s): Long term tolerability and safety of Temferon as determined by the incidence of adverse events up to 1 year following Temferon administration according to CTCAE v5.0 criteria, Incidence, severity and duration of adverse events of special interest as indicated on the study protocol, Proportion of patients achieving hematological recovery by Day +30, Identification of the presence of transduced myeloid cells in bone marrow, Identification of the presence of transduced myeloid cells in peripheral blood, Evaluate persistent transduced myeloid cells in peripheral blood, Change in functional status (Eastern Cooperative Oncology Group), Overall response rate per RECIST version 1.1, at Baseline and at anytime after Temferon infusion, defined as the proportion of patients who achieved a complete or partial response as their best overall response, Median progression-free survival following Temferon infusion, Median overall survival following Temferon infusion, Disease control rate following Temferon infusion, Time to progression following Temferon infusion, Primary and / or secondary tumor biopsy and biomarker analyses

Source: https://euclinicaltrials.eu/ctis-public/view/2024-512898-27-00